EU clinical trial 2023-507865-24-00: Integrated PK/efficacy, safety, and immunogenicity study to demonstrate similarity of JPB898, a proposed biosimilar to nivolumab, to Opdivo® in combination with Yervoy®
Protocol code: CJPB898A12301
Sponsor: H e x a l AG (Pharmaceutical company). Phase: Therapeutic confirmatory (Phase III). Countries: Bulgaria (ended), Italy (ended), Hungary (ended), Lithuania (ended), Germany (ended), Spain (ended), Czechia (ended), Greece (ended), Portugal (ended), Romania (ended), Poland (ended).
Therapeutic area(s): Diseases [C] - Neoplasms [C04]
Gender: Female, Male. Age: 18-64 years, 65+ years. Enrolment: 302.
Status: Ended. Start date (EU): 2025-03-28. End date (EU): 2025-10-27. End date: 2026-01-23. Decision date: 2024-07-17. Results received: No. Last updated: 2025-12-02.
Decision dates by country: LT: 2024-07-22, BG: 2024-07-22, CZ: 2024-07-17, IT: 2024-07-17, DE: 2024-07-19, RO: 2024-07-22, PT: 2024-07-19, HU: 2024-07-19, PL: 2024-07-22, ES: 2024-07-17, GR: 2024-07-22

Condition(s): Advanced (unresectable/metastatic) melanoma

Source: https://euclinicaltrials.eu/ctis-public/view/2023-507865-24-00